EU clinical trial 2024-515600-39-00: ABATACEPT VERSUS TOCILIZUMAB BY SUBCUTANEOUS ADMINISTRATION FOR THE TREATMENT OF RHEUMATOID ARTHRITIS IN TARGETED TREATMENT INADEQUATE RESPONDER PATIENTS: A RANDOMIZED, OPENLABELED, SUPERIORITY TRIAL. -SUNSTAR-
Protocol code: RC-P0055
Sponsor: Groupement Des Hopitaux De L'Institut Catholique De Lille (Hospital/Clinic/Other health care facility). Phase: Therapeutic use (Phase IV). Countries: France (ended).
Therapeutic area(s): Diseases [C] - Musculoskeletal Diseases [C05]
Gender: Female, Male. Age: 18-64 years, 65+ years. Enrolment: 224.
Status: Ended. Start date (EU): 2018-01-23. End date (EU): 2026-01-29. Decision date: 2024-07-31. Results received: No. Last updated: 2024-07-31.

Condition(s): Adults patients suffering from rheumatoid arthritis and in adequate response to one or two targeted treatments.
Product: ORENCIA 125 mg solution for injection in pre-filled syringe, ORENCIA 125 mg solution for injection in pre-filled syringe, RoActemra 162 mg solution for injection in pre-filled syringe., ORENCIA 125 mg solution for injection in pre-filled syringe, ORENCIA 125 mg solution for injection in pre-filled syringe, RoActemra 162 mg solution for injection in pre-filled syringe., ORENCIA 125 mg solution for injection in pre-filled syringe, ORENCIA 125 mg solution for injection in pre-filled syringe, ORENCIA 125 mg solution for injection in pre-filled syringe

Primary endpoint: Evolution of the Clinical Disease Activity Index (CDAI) at 6 months. The CDAI is a composite score combining clinical items only: Tender 28- joint count, Swollen 28-joint count, Patient Global Disease (PGA), Evaluator's Global Disease Activity (EGA). This score provides a numerical assessment reflecting disease activity independently of acute phase reactants.
Endpoint(s): 1/ Secondary outcomes will assess treatment response. Comparisons will be made between the baseline level (M0) and the level observed at 3, 6 and 12 months for : - DAS28-ESR and DAS28-CRP - SDAI : - HAQ, SF-36 FLARE-RA quality of life score - PGA and EGA VAS - CDAI and DAS28-ESR LDA (low disease activity) - Proportion of patients achieving good or moderate European League Against Rheumatism (EULAR) therapeutic response (DS28-ESR) - Proportion of patients achieving ACR20, ACR50, and ACR70 respons, 2/ Tolerance observed at 3, 6 and 12 months - Proportion of patients presenting at least one side effect, according to NCI-CTCAE v4.0 scale: (Platelets, AST/ALT, Triglycerides, Neutropenia) - Rates of treatment withdrawals for intolerance - Rates of treatment withdrawals for intolerance requiring in-hospital care - Rate of rescue medication use authorized by the protocol and treatment dose, 3/ Radiobiological criteria for a better understanding of pathophysiological phenomena: - changes in joint US-Doppler synovitis and Doppler hyperemia grade of the hands and wrists at 6 months - changes in Sharp score of hands, wrists and feets radiographs at 12 months - change in Vascular Endothelial Growth Factor (VEGF) levels at 3 and 6 months - changes in interleukin-6 plasma levels at 6 months, 4/ The treatment failure rate is defined at 3, 6 and 12 months by :o a change in treatment between the assessment visit and the previous visit (apart from breaks ≤ 30d, discontinuation without relapse ≤ 30d, and dose modification) o and/or CDAI > 10 for the treatment considered at the assessment visit o and/or corticosteroid therapy > 10 mg/d prior to the assessment visit, and past 3 months o and/or cortisone derivative infiltration prior to the assessment visit, and past 3 months

Source: https://euclinicaltrials.eu/ctis-public/view/2024-515600-39-00